EU clinical trial 2023-504100-28-00: Randomized, double-blind, placebo-controlled study on the efficacy and safety of nicotinamide in patients with liver fibrosis.
Protocol code: IIBSP-NIC-2021-157
Sponsor: Fundacio Institut De Recerca De L Hospital De La Santa Creu I Sant Pau (Hospital/Clinic/Other health care facility). Phase: Therapeutic exploratory (Phase II). Countries: Spain (ongoing, recruiting).
Therapeutic area(s): Diseases [C] - Digestive System Diseases [C06]
Gender: Female, Male. Age: 18-64 years, 65+ years. Enrolment: 30.
Status: Ongoing, recruiting. Start date (EU): 2024-01-02. Decision date: 2023-06-05. Results received: No. Last updated: 2025-07-23.

Condition(s): Hepatic fibrosis
Product: NICOTINAMIDE

Primary endpoint: Changes in liver stiffness measured by Fibroscan® at 12 months after the start of treatment compared to baseline., Changes in the quantification of intrahepatic fat measured by CAP at 12 months after the start of treatment compared to the initial value., Changes in the value obtained through the ELFTM Test (metabolomics-based methodology) at 12 months after the start of treatment compared to the initial value., Histological changes in case of final liver biopsy in patients with a biopsy prior to the start of the study.
Endpoint(s): Changes in the distribution of body adiposity, measured by bioimpedance at 12 months after the start of treatment with respect to the initial value., Cambios en la composición relativa de la microbiota intestinal analizada en heces mediante metabolómica y de las concentraciones séricas de metabolitos relacionados con su metabolismo, a lo largo del tratamiento (basal, 3, 6, y 12 meses)., Changes in circulating levels of cytokines/adipokines related to systemic inflammation throughout treatment (baseline, 3, 6, and 12 months). This point will be assessed at the end of the study, by means of a sample from the biobank.

Source: https://euclinicaltrials.eu/ctis-public/view/2023-504100-28-00